EU clinical trial 2023-510369-92-00: A Randomized, Double-Blind, Placebo-Controlled, Parallel-Group, Phase 2 Trial Evaluating the Efficacy and Safety of RBD5044 in Patients with Mixed Dyslipidemia
Protocol code: RC02T001
Sponsor: Ribocure Pharmaceuticals AB (Pharmaceutical company). Phase: Therapeutic exploratory (Phase II). Countries: Sweden (ongoing, recruiting), Poland (ongoing, recruiting).
Therapeutic area(s): Diseases [C] - Cardiovascular Diseases [C14]
Gender: Female, Male. Age: 18-64 years, 65+ years. Enrolment: 160.
Status: Ongoing, recruiting. Start date (EU): 2025-01-28. Decision date: 2024-10-28. Results received: No. Last updated: 2026-06-15.
Decision dates by country: PL: 2026-05-25, SE: 2024-10-28

Condition(s): Mixed Dyslipidemia
Product: RBD3000 Placebo Injection is a clear, colorless sterile solution for subcutaneous injection, which is formulated by 25 mM phosphate buffer

Primary endpoint: Percent change from baseline in TG levels at week 16.
Endpoint(s): Frequency, intensity and seriousness of the AEs during the trial. Clinically significant changes in laboratory parameters, vital signs, physical examinations and 12-lead ECG at each visit from baseline to week 48 (end of trial)., Percent change from baseline in TG levels at week 4, 8, 12, 20, 24, 32, 40 and 48., Percent change from baseline in apoC-III levels at week 4, 8, 12, 16, 20, 24, 32, 40 and 48., Plasma concentrations of RBD5044 will be summarized with descriptive statistics by sampling collection time point., Percent change from baseline in lipid parameters TC, LDL-C, HDL-C, non-HDL-C, TRL-C, ApoB, ApoA1, Lp (a) at week 4, 8, 12, 16, 20, 24, 32, 40 and 48.

Source: https://euclinicaltrials.eu/ctis-public/view/2023-510369-92-00